EU clinical trial 2022-502372-22-01: SAFIR 03_A ctDNA screening program in patients with HR+, HER2- metastatic breast cancer for detection of high-risk relapse patients on any CDK4/6 inhibitor and a randomised phase II study comparing alpelisib combined with fulvestrant to ribociclib combined with fulvestrant, in patients with persistent targetable PIK3CA mutations.
Protocol code: UC-GMP-2206
Sponsor: Unicancer (Hospital/Clinic/Other health care facility). Phase: Therapeutic exploratory (Phase II). Countries: France (ended).
Therapeutic area(s): Diseases [C] - Neoplasms [C04]
Gender: Female, Male. Age: 18-64 years, 65+ years. Enrolment: 1080.
Status: Ended. Start date (EU): 2023-10-19. End date (EU): 2025-11-24. Decision date: 2023-07-21. Results received: No. Last updated: 2025-02-28.

Condition(s): Metastatic Breast Cancer HR+, HER2-
Product: Kisqali 200 mg film-coated tablets, FULVESTRANT, ALPELISIB, ALPELISIB, GOSERELIN, TRIPTORELIN, LEUPRORELIN, Kisqali 200 mg film-coated tablets

Primary endpoint: The primary endpoint is the progression free survival (PFS).
Endpoint(s): Efficacy endpoint for randomised patients - Overall survival (OS): OS is defined as the time interval between the date of randomisation and the date of death, from any cause. Patients still alive at the cut-off time (including lost to follow-up) will be censored at the last known alive date., Efficacy endpoint for randomised patients - Objective response Rate (ORR): ORR will be assessed by the investigators using RECIST V1.1and is defined as the proportion of patients with a best overall response of complete response (CR) or partial response (PR) during treatment., Efficacy endpoint for randomised patients - Duration of response (DoR) is defined as the time interval from the date of first documented CR or PR to the date of first documented disease progression or death, from any cause. Patients without progression at the cut-off date will be censored at the last tumour assessment date., Efficacy endpoint for randomised patients - Clinical Benefit Rate (CBR): CBR will be and assessed by the investigators using RECIST v1.1. and is defined as the proportion of patients with a best overall response of complete response (CR), partial response (PR) or stable disease during treatment., Efficacy endpoint for randomised patients - Time to Response (TTR): TTR is defined, for subjects with an OR according to RECIST v1.1, as the time from randomisation to the first documentation of OR which is subsequently confirmed., Efficacy endpoint for non-randomised patients - Overall survival (OS): OS is defined as the time interval between the date of initiation of standard of care and the date of death, from any cause. Patients still alive at the cut-off time (including lost to follow-up) will be censored at the last known alive date., Efficacy endpoint for non-randomised patients - Progression Free Survival (PFS): PFS is defined as the time interval between the date of initiation of standard of care to the date of the first documented disease progression or death, whatever the cause. The tumour assessments are made by the investigators and based on RECIST 1.1, Safety endpoint is the assessment of the incidences of adverse events, graded by NCI CTC-AE v5.

Source: https://euclinicaltrials.eu/ctis-public/view/2022-502372-22-01